EU clinical trial 2024-511405-27-00: A Multiple-Ascending-Dose Study of MK-1708 in Healthy Participants
Protocol code: MK-1708-002
Sponsor: Merck Sharp & Dohme LLC (Pharmaceutical company). Phase: Human Pharmacology (Phase I)- Other. Countries: Belgium (ended).
Therapeutic area(s): Diseases [C] - Nervous System Diseases [C10]
Gender: Female, Male. Age: 18-64 years. Enrolment: 32.
Status: Ended. Start date (EU): 2024-05-08. End date (EU): 2024-09-16. End date: 2024-09-17. Decision date: 2024-04-29. Results received: No. Last updated: 2024-08-30.

Condition(s): Amyotrophic lateral sclerosis and Alzheimer’s disease

Source: https://euclinicaltrials.eu/ctis-public/view/2024-511405-27-00